EU clinical trial 2023-508874-27-00: COmbiNed eFfIcacy and safety of an eaRly, intensive MAnagement sTrategy with fInerenOne and SGLT2 iNhibitor in patients hospitalized with Heart Failure (CONFIRMATION-HF)
Protocol code: 202303CPC
Sponsor: Colorado Prevention Center (Hospital/Clinic/Other health care facility). Phase: Therapeutic confirmatory (Phase III). Countries: Spain (ongoing, recruiting).
Therapeutic area(s): Diseases [C] - Cardiovascular Diseases [C14]
Gender: Female, Male. Age: 18-64 years, 65+ years. Enrolment: 150.
Status: Ongoing, recruiting. Start date (EU): 2025-12-02. Decision date: 2025-02-27. Results received: No. Last updated: 2026-05-08.

Condition(s): Heart condition
Product: BAY 94-8862, Finerenone, Jardiance 10 mg film-coated tablets, Finerenone

Primary endpoint: The primary endpoint is clinical benefit, defined as a hierarchical composite endpoint of: 1. Time to all-cause mortality 2. Number of total HF events 3. Time to first HF event 4. KCCQ-TSS change from baseline to 6 months of 5 points or greater assessed by the win-ratio method
Endpoint(s): Secondary endpoints include treatment group difference in: • KCCQ-TSS, mean change from baseline to 6 months • Time to first occurrence of all-cause mortality or HF event (hospitalization for HF or urgent visit due to HF) • Total (first and recurrent) HF events from baseline to 90 days

Source: https://euclinicaltrials.eu/ctis-public/view/2023-508874-27-00